EU clinical trial 2024-515075-36-00: Multicenter randomized two arms study evaluating the efficacy of prophylactic Rituximab in EBV negative kidney transplant recipients on incidence of EBV primary infection and post-transplant lymphoproliferative disorders - REPLY
Protocol code: 7678
Sponsor: Les Hopitaux Universitaires De Strasbourg (Hospital/Clinic/Other health care facility). Phase: Therapeutic use (Phase IV). Countries: France (ongoing, recruiting).
Therapeutic area(s): Diseases [C] - Virus Diseases [C02]
Gender: Female, Male. Age: 0-17 years, 18-64 years, 65+ years. Enrolment: 100.
Status: Ongoing, recruiting. Start date (EU): 2021-12-01. Decision date: 2024-07-01. Results received: No. Last updated: 2026-01-19.

Condition(s): kidney transplantion -Epstein Barr virus
Product: RITUXIMAB

Primary endpoint: 1 year incidence of a composite criteria: EBV primary infection assessed by a positive blood EBV viral load and/or EBV seroconversion ; and/or occurrence of a post-transplant lymphoproliferative disorder
Endpoint(s): 1, 2, 3, 4 and 5 years incidence of PTLD after kidney transplantation, Incidence of primary EBV infection evaluated by EBV viremia (PCR blood test) at M1, M2, M3, M6, M12, M24, M36, M48, M60 and EBV seroconversion at M1, M3, M6, M12, M24, M36, M48, M60., Delay of occurrence of primary EBV infection, Delay of occurrence of primary EBV infection, CD19/CD20 reconstitution at M3, M6, M12, M24, Number of patients with high EBV viral load who need Rituximab for preemptive therapy in each group, Graft loss at M1, M2, M3, M6, M12, M24, M36, M48, M60, Allograft kidney function evaluated by CKD-EPI formula or by Schwartz formula in pediatric patients at M1, M2, M3, M6, M12, M24, M36, M48, M60Recipient survival at M1, M2, M3, M6, M12, M24, M36, M48, M60, Incidence of opportunistic infections and malignancies at M1, M2, M3, M6, M12, M24, M36, M48, M60, Incidence of BKV viremia (PCR blood test) M1, M3, M6, M12 and M24, Delay of BKV viremia, Incidence of CMV viremia (PCR blood test) at M1, M3, M6, M12 and XML File Identifier: BMpUWXavs2G+LuOr9Bi86K8SCls= Page 12/29 M24, Treatment tolerance: allergic reaction, neutropenia, hospitalization for febrile neutropenia, hypogammaglobulinémia, AE/SAE, All these end points in specific pediatric and adult sub groups

Source: https://euclinicaltrials.eu/ctis-public/view/2024-515075-36-00